EU clinical trial 2023-503837-23-00: An Open-Label Extension to Investigate the Long-Term Safety, Tolerability, and Efficacy of DNL310 in Patients With Mucopolysaccharidosis Type II (MPS II) From Study DNLI-E-0002 or Study DNLI-E-0007
Protocol code: DNLI-E-0008
Sponsor: Denali Therapeutics Inc. (Pharmaceutical company). Phase: Therapeutic confirmatory (Phase III). Countries: Italy (ongoing, recruiting), Belgium (ongoing, recruiting), Sweden (ongoing, recruiting), Spain (ongoing, recruiting), Czechia (ongoing, recruiting), Germany (ongoing, recruiting), Netherlands (ongoing, recruiting), France (ongoing, recruiting).
Therapeutic area(s): Diseases [C] - Nervous System Diseases [C10]
Gender: Female, Male. Age: 0-17 years, 18-64 years. Enrolment: 30.
Status: Ongoing, recruiting. Start date (EU): 2023-12-12. Decision date: 2023-11-06. Results received: No. Last updated: 2026-02-09.
Decision dates by country: BE: 2023-11-06, CZ: 2024-02-05, NL: 2024-02-05, IT: 2023-11-08, ES: 2023-12-26, DE: 2024-02-12, SE: 2023-11-07, FR: 2024-02-07

Condition(s): Mucopolysaccharidosis Type II [MPS II]

Primary endpoint: 1. Incidence and intensity of treatment emergent adverse events (TEAEs) throughout the treatment period [Time Frame: 5 years] 2. Incidence and intensity of infusion related reactions (IRRs) throughout the treatment period [Time Frame: 5 years]
Endpoint(s): 1.Percent change from baseline in CSF HS concentration [Time Frame: 240 weeks], 2. Change from baseline in the Vineland-3 [Time Frame: 240 weeks], 3.Change from baseline in the Vineland-3 ABC [Time Frame: 240 weeks], 4.Change from baseline in the BSID III cognitive raw score [Time Frame: 240 weeks], 5. Percent change from baseline in serum NfL [Time Frame: 240 weeks], 6.Change from baseline in distance walked (meters) in the 6MWT [Time Frame: 240 weeks], 7.Percent change from baseline in the sum of urine HS and dermatan sulfate concentrations [Time Frame: 240 weeks], 8.Liver volume within the normal range (normal vs abnormal) as measured by MRI [Time Frame: 240 weeks], 9.Spleen volume within the normal range (normal vs abnormal) as measured by MRI [Time Frame: 240 weeks], 10.Improvement in CaGI C Overall MPS II (defined as much improved or a little improved) [Time Frame: 240 weeks]

Source: https://euclinicaltrials.eu/ctis-public/view/2023-503837-23-00